EU clinical trial 2022-500637-80-00: (Peak) A Phase 3 Randomized, Open-label, Multicenter Clinical Study of CGT9486+Sunitinib vs Sunitinib in Subjects with Locally Advanced, Unresectable, or Metastatic Gastrointestinal Stromal Tumors
Protocol code: CGT9486-21-301
Sponsor: Cogent Biosciences Inc. (Pharmaceutical company). Phase: Therapeutic confirmatory (Phase III). Countries: Germany (ongoing, recruitment ended), Spain (ongoing, recruitment ended), Sweden (ongoing, recruitment ended), Denmark (ongoing, recruitment ended), Hungary (ended), France (ongoing, recruitment ended), Czechia (ongoing, recruitment ended), Netherlands (ongoing, recruitment ended), Italy (ongoing, recruitment ended), Poland (ongoing, recruitment ended), Norway (ongoing, recruitment ended).
Therapeutic area(s): Diseases [C] - Neoplasms [C04]; Diseases [C] - Digestive System Diseases [C06]
Gender: Female, Male. Age: 18-64 years, 65+ years. Enrolment: 114.
Start date (EU): 2023-03-28. Decision date: 2022-09-26. Results received: No. Last updated: 2026-05-26.
Decision dates by country: IT: 2022-09-29, FR: 2022-09-30, DK: 2022-09-26, PL: 2022-10-04, NO: 2022-11-15, SE: 2022-10-03, HU: 2022-09-30, ES: 2022-10-03, CZ: 2022-10-03, DE: 2022-09-28, NL: 2022-10-03

Condition(s): gastrointestinal stromal tumor
Product: CGT9486, SUNITINIB, SUNITINIB, CGT9486

Primary endpoint: Part 2: PFS (defined as the time from randomization to disease progression or death from any cause, whichever occurs first) as determined by BICR using mRECIST v1.1
Endpoint(s): Part 2 (key sec.): OS, defined as the time from randomization until the date of death, Part 2 (key sec.): ORR, as determined by BICR using mRECIST v1.1

Source: https://euclinicaltrials.eu/ctis-public/view/2022-500637-80-00